EU clinical trial 2023-509406-30-00: A Phase 2/3 Study of ALX148 in Patients with Advanced HER2-Overexpressing Gastric/Gastroesophageal Junction Adenocarcinoma (ASPEN-06)
Protocol code: AT148006
Sponsor: Alx Oncology Inc. (Pharmaceutical company). Phase: Phase II and Phase III (Integrated). Countries: Belgium (ended), Spain (ended), Italy (ended), Czechia (ended), France (ended).
Therapeutic area(s): Diseases [C] - Digestive System Diseases [C06]
Gender: Female, Male. Age: 18-64 years, 65+ years. Enrolment: 87.
Status: Ended. Start date (EU): 2022-01-24. End date (EU): 2026-06-15. End date: 2026-06-29. Decision date: 2024-02-27. Results received: No. Last updated: 2026-05-29.
Decision dates by country: BE: 2024-02-28, CZ: 2024-03-01, FR: 2024-03-01, IT: 2024-03-01, ES: 2024-02-27

Condition(s): Patients with HER2-overexpressing advanced or metastatic gastric or gastroesophageal junction (GEJ) adenocarcinoma that has progressed on or after a prior HER2-directed agent and fluoropyrimidine- or platinum-containing chemotherapy (2nd-line or 3rd-line)
Product: Cyramza 10 mg/ml concentrate for solution for infusion, evorpacept, Paclitaxel 6 mg/mL concentrate for solution for infusion, Herceptin 150 mg powder for concentrate for solution for infusion, Normal Saline (Sodium Chloride)

Primary endpoint: Phase II: Objective response rate (ORR; CR or PR using the Response Evaluation Criteria in Solid Tumors [RECIST] version 1.1 for solid tumors) based on investigator assessment. Dropouts will be analyzed as non-responders., Phase III: Overall survival (OS)
Endpoint(s): Phase II: Objective response rate (ORR; CR or PR using the Response Evaluation Criteria in Solid Tumors [RECIST] version 1.1 for solid tumors) based on blinded independent central review (BICR)., Phase II: Duration of response (DoR), disease control rate (DCR), time to tumor progression (TTP) based on investigator and BICR assessment., Phase II: Progression-free survival (PFS) based on investigator and BICR assessment, and overall survival (OS)., Phase II: Adverse Events as characterized by type, frequency, severity (as graded by National Cancer Institute Common Terminology Criteria for Adverse Events (NCI CTCAE v. 5.0), timing, seriousness, and relationship to study therapy;, Phase II: Laboratory abnormalities as characterized by type, frequency, severity (as graded by NCI CTCAE v. 5.0) and timing., Phase II: Pharmacokinetic exposure of ALX148 such as trough (pre-infusion) and peak (post-infusion) serum ALX148 concentrations;, Phase II: Immunogenicity characterized by the presence or absence of serum anti-ALX148 antibodies., Phase III: Objective response rate (ORR), Disease control rate (DCR), duration of response (DoR), and time to tumor progression (TTP) based on both blinded independent central review and investigator assessment., Phase III: Progression-free survival (PFS) based on both blinded independent central review and investigator assessment., Phase III: Adverse Events as characterized by type, frequency, severity (as graded by National Cancer Institute Common Terminology Criteria for Adverse Events (NCI CTCAE v. 5.0), timing, seriousness, and relationship to study therapy., Phase III: Laboratory abnormalities as characterized by type, frequency, severity (as graded by NCI CTCAE v. 5.0) and timing., Phase III: Pharmacokinetic exposure of ALX148 such as trough (pre-infusion) and peak (post-infusion) serum ALX148 concentrations., Phase III: Immunogenicity characterized by the presence or absence of serum anti-ALX148 antibodies., Phase III: Quality of life measurements as characterized by the EORTC QLQ-C30 and QLQ-STO22 questionnaires.

Source: https://euclinicaltrials.eu/ctis-public/view/2023-509406-30-00